EU clinical trial 2023-508422-95-00: An open-label, multicenter Phase 1/2 dose escalation and expansion study of THOR-707 as a single agent and as a combination therapy in adult subjects with advanced or metastatic solid tumors
Protocol code: TCD16843
Sponsor: Synthorx Inc. (Pharmaceutical company). Phase: Phase I and Phase II (Integrated)- Other. Countries: Spain (ended).
Therapeutic area(s): Diseases [C] - Neoplasms [C04]
Gender: Female, Male. Age: 18-64 years, 65+ years. Enrolment: 31.
Status: Ended. Start date (EU): 2023-05-25. End date (EU): 2025-12-02. Decision date: 2024-02-07. Results received: No. Last updated: 2025-11-13.

Condition(s): Cancer
Product: DIPHENHYDRAMINE, FAMOTIDINE, PEGENZILEUKIN, TOCILIZUMAB, ONDANSETRON, DEXAMETHASONE, PARACETAMOL

Primary endpoint: Rate of Dose-Limiting Toxicities (DLTs) - Cohorts A, B, C, and D, Rate of Dose-Limiting Toxicities (DLTs) -Cohort G, Maximum Tolerated Dose (MTD)- Cohorts A, B, C, and D, Recommended Phase 2 Dose (RP2D) or THOR-707- Cohorts A, B, C, and D, Recommended Phase 2 Dose (RP2D) of THOR-707- Cohort G, Maximum Tolerated Dose (MTD)- Cohort G, Number of participants with treatment emergent adverse events, serious adverse events, and laboratory abnormalities – Cohorts A, B, C, D, E, F, and G, Objective Response Rate (ORR) according to RECIST version 1.1 -Cohort H
Endpoint(s): ORR according to RECIST version 1.1 Cohort A, B, C, D, E, F, and G), Duration of Response (DOR) according to RECIST version 1.1, Progression-Free Survival (PFS) according to RECIST version 1.1, Overall Survival according to RECIST version 1.1, Time to Response (TTR) according to RECIST version 1.1, Disease Control Rate (DCR) according to RECIST version 1.1, Percentage of subjects with no disease progression at 6 months post-treatment, Number of participants with treatment emergent adverse events, serious adverse events, laboratory abnormalities -Cohort H

Source: https://euclinicaltrials.eu/ctis-public/view/2023-508422-95-00